EU clinical trial 2023-507134-25-00: An open-label cocktail drug-drug interaction (DDI) clinical study to assess the effect of multiple oral dosing with leniolisib on the pharmacokinetics (PK) of caffeine, midazolam, rosuvastatin, furosemide, and metformin in healthy subjects
Protocol code: LE 5101
Sponsor: Pharming Technologies B.V. (Pharmaceutical company). Phase: Human Pharmacology (Phase I)- Other. Countries: Germany (ended).
Therapeutic area(s): Diseases [C] - Immune System Diseases [C20]
Gender: Female, Male. Age: 18-64 years. Enrolment: 20.
Status: Ended. Start date (EU): 2024-01-29. End date (EU): 2024-04-02. Decision date: 2024-01-08. Results received: No. Last updated: 2024-01-08.

Condition(s): Activated Phosphoinositide 3-Kinase Delta Syndrome

Source: https://euclinicaltrials.eu/ctis-public/view/2023-507134-25-00